EU clinical trial 2022-502605-15-00: Open-label extension study of long-term safety and efficacy of NNC6019-0001 in participants with transthyretin amyloid cardiomyopathy (ATTR CM)
Protocol code: NN6019-7565
Sponsor: Novo Nordisk A/S (Pharmaceutical company). Phase: Therapeutic exploratory (Phase II). Countries: Italy (ongoing, recruitment ended), Czechia (ongoing, recruitment ended), Netherlands (ongoing, recruitment ended), France (ongoing, recruitment ended), Spain (ongoing, recruitment ended), Germany (ongoing, recruitment ended), Portugal (ongoing, recruitment ended).
Therapeutic area(s): Diseases [C] - Cardiovascular Diseases [C14]
Gender: Female, Male. Age: 18-64 years, 65+ years. Enrolment: 58.
Status: Ongoing, recruitment ended. Start date (EU): 2024-09-16. Decision date: 2024-05-29. Results received: No. Last updated: 2026-03-13.
Decision dates by country: IT: 2024-05-31, NL: 2024-06-03, CZ: 2024-05-30, ES: 2024-05-30, FR: 2024-05-30, PT: 2024-05-29, DE: 2024-05-30

Condition(s): Participants with transthyretin amyloid cardiomyopathy (ATTR CM)
Product: GADOTERIC ACID, PARACETAMOL, coramitug, CETIRIZINE, SODIUM CHLORIDE

Primary endpoint: Number of treatment emergent adverse events from baseline (week 0) up to visit 39 (week 156)
Endpoint(s): Change in 6-minute walk test (6MWT) from baseline (week 0) to visit 28 (week 104), Change in NT-proBNP from baseline (week 0) to visit 28 (week 104), Change in myocardial extracellular volume from baseline (week 0) to visit 28 (week 104), Change in KCCQ-(CSS)2 from baseline (week 0) to visit 28 (week 104), Change in troponin I from baseline (week 0) to visit 28 (week 104), Change in GLS on echocardiography from baseline (week 0) to visit 28 (week 104)

Source: https://euclinicaltrials.eu/ctis-public/view/2022-502605-15-00